EU clinical trial 2023-507823-52-00: Sodium zirconium cyclosilicate to allow liberal fruit and vegetable intake for patients with CKD stage 3b and 4 (LIBERAL study)
Sponsor: Academisch Ziekenhuis Leiden (Hospital/Clinic/Other health care facility). Phase: Therapeutic confirmatory (Phase III). Countries: Netherlands (ended).
Therapeutic area(s): Diseases [C] - Nutritional and Metabolic Diseases [C18]
Gender: Female, Male. Age: 18-64 years, 65+ years. Enrolment: 16.
Status: Ended. Start date (EU): 2024-05-27. End date (EU): 2025-03-12. Decision date: 2024-02-27. Results received: No. Last updated: 2024-11-28.
Decision dates by country: NL: 2024-04-04

Condition(s): Patients with chronic kidney disease stage 3b to 4
Product: Lokelma 5 g powder for oral suspension, Lokelma 10 g powder for oral suspension

Primary endpoint: The difference of serum potassium at baseline and after six weeks of treatment with potassium enriched diet (non-inferiority design) compared to the control group. With an intention to treat analysis.
Endpoint(s): Ambulatory blood pressure, 24 hours albuminuria, urinary potassium and sodium excretion, Plasma bicarbonate, Quality of life, using SF36 questionnaire, Effect on stool (assessed with Bristol Stool Chart), Difference in serum potassium one week after start of study (SCZ free period), Per protocol analysis of difference in serum potassium after six week (end of study), Incidence of severe hyperkalemia (serum potassium above 6.5 mmol/l or above 6.0 with ECG features of hyperkalemia)

Source: https://euclinicaltrials.eu/ctis-public/view/2023-507823-52-00